EU clinical trial 2024-511041-19-00: A Phase 2b, Randomized, Active-Controlled, Double-Blind, Dose-Ranging Clinical Study to Evaluate a Switch to Islatravir (ISL) and MK-8507 Once-Weekly in Adults with HIV-1 Virologically Suppressed on Bictegravir/Emtricitabine/Tenofovir Alafenamide (BIC/FTC/TAF) Once-Daily
Protocol code: MK-8591-013
Sponsor: Merck Sharp & Dohme LLC (Pharmaceutical company). Phase: Therapeutic exploratory (Phase II). Countries: France (ended).
Therapeutic area(s): Diseases [C] - Virus Diseases [C02]
Gender: Female, Male. Age: 18-64 years, 65+ years. Enrolment: 48.
Status: Ended. Start date (EU): 2021-04-06. End date (EU): 2025-01-28. End date: 2025-01-30. Decision date: 2024-04-17. Results received: Yes. Last updated: 2025-01-29.

Condition(s): HIV-1 Infection
Product: Placebo to ISL, Placebo to MK-8507, Placebo to BIC/FTC/TAF, EMTRICITABINE, TENOFOVIR ALAFENAMIDE AND BICTEGRAVIR, islatravir, ulonivirine

Primary endpoint: Percentage of participants with ≥1 adverse event (AE), Percentage of participants discontinuing study intervention due to AE

Source: https://euclinicaltrials.eu/ctis-public/view/2024-511041-19-00